EU clinical trial 2024-514637-37-00: REGOSTA – A multicentre exploratory phase II study describing the efficacy and safety of regorafenib as maintenance therapy after first-line treatment in patients with bone sarcomas
Protocol code: ET18-272
Sponsor: Centre Leon Berard (Hospital/Clinic/Other health care facility). Phase: Therapeutic confirmatory (Phase III). Countries: France (temporarily halted).
Therapeutic area(s): Diseases [C] - Neoplasms [C04]
Gender: Female, Male. Age: 0-17 years, 18-64 years, 65+ years. Enrolment: 60.
Status: Temporarily halted. Start date (EU): 2020-02-11. Decision date: 2024-08-13. Results received: No. Last updated: 2026-01-06.

Condition(s): Patients with bone sarcomas other than chordoma, who have no residual disease after their standard treatment sequence.
Product: The placebo refers to the IMP Stivarga 40 mg film-coated tablets, BAY 73-4506

Primary endpoint: The primary endpoint will be the 36-month Relapse-Free Survival rate (36M-RFS). An event will be described as the recurrence of the disease, either local or distant, determined locally by the investigational staff.

Source: https://euclinicaltrials.eu/ctis-public/view/2024-514637-37-00